EU clinical trial 2024-514173-22-00: A Phase 3, Open-label Study Evaluating the Long-term Safety and Efficacy of VX-121/TEZ/D-IVA Combination Therapy in Subjects With Cystic Fibrosis
Protocol code: VX20-121-104
Sponsor: Vertex Pharmaceuticals Inc. (Pharmaceutical company). Phase: Therapeutic confirmatory (Phase III). Countries: Italy (ongoing, recruitment ended), Germany (ongoing, recruitment ended), Greece (ongoing, recruitment ended), Austria (ongoing, recruitment ended), Spain (ongoing, recruitment ended), Ireland (ongoing, recruitment ended), Czechia (ongoing, recruitment ended), Norway (ongoing, recruitment ended), Sweden (ongoing, recruitment ended), Denmark (ongoing, recruitment ended), Netherlands (ongoing, recruitment ended), Portugal (ongoing, recruitment ended), Belgium (ongoing, recruitment ended), France (ongoing, recruitment ended), Hungary (ongoing, recruitment ended), Poland (ongoing, recruitment ended).
Therapeutic area(s): Diseases [C] - Respiratory Tract Diseases [C08]
Gender: Female, Male. Age: 0-17 years, 18-64 years, 65+ years. Enrolment: 331.
Status: Ongoing, recruitment ended. Start date (EU): 2023-02-28. Decision date: 2024-06-25. Results received: No. Last updated: 2026-06-29.
Decision dates by country: AT: 2024-07-01, BE: 2024-06-25, CZ: 2024-06-28, DK: 2024-06-26, FR: 2024-06-26, DE: 2024-06-27, GR: 2024-08-02, HU: 2024-06-26, IE: 2024-06-25, IT: 2024-07-01, PT: 2024-06-27, ES: 2024-06-26, SE: 2024-06-25, NL: 2024-06-28, NO: 2024-06-27, PL: 2024-07-01

Condition(s): Cystic Fibrosis
Product: VX-121/VX-661/VX-561 Film-coated tablet, Alyftrek 125 mg/50 mg/10 mg film-coated tablets

Primary endpoint: Safety and tolerability of long-term treatment with VX-121/TEZ/D-IVA based on adverse events, clinical laboratory values, ECGs, vital signs, and pulse oximetry
Endpoint(s): Absolute change from baseline in percent predicted forced expiratory volume in 1 second (ppFEV1), Absolute change from baseline in sweat chloride (SwCl), Number of pulmonary exacerbations (PEx)

Source: https://euclinicaltrials.eu/ctis-public/view/2024-514173-22-00